EU clinical trial 2023-504904-26-00: A Randomized, Double-blind, Placebo-controlled, Multinational, Phase 3 Study of the Efficacy and Safety of Inhaled Treprostinil in Subjects with Progressive Pulmonary Fibrosis (TETON-PPF)
Protocol code: RIN-PF-305
Sponsor: United Therapeutics Corp. (Pharmaceutical company). Phase: Therapeutic confirmatory (Phase III). Countries: Belgium (ongoing, recruiting), Italy (ongoing, recruiting), Spain (ongoing, recruiting), France (ongoing, recruiting), Germany (ongoing, recruiting).
Therapeutic area(s): Diseases [C] - Respiratory Tract Diseases [C08]
Gender: Female, Male. Age: 18-64 years, 65+ years. Enrolment: 242.
Status: Ongoing, recruiting. Start date (EU): 2025-04-07. Decision date: 2025-03-17. Results received: No. Last updated: 2026-07-06.
Decision dates by country: FR: 2025-04-03, DE: 2025-03-19, IT: 2025-03-24, ES: 2025-03-28, BE: 2025-03-18

Condition(s): Progressive Pulmonary Fibrosis
Product: Treprostinil, The Placebo Nebuliser Solution is a solution dosage form for nebulisation identical to Treprostinil Nebuliser Solution drug product except for the absence of the treprostinil drug substance.

Primary endpoint: Change in absolute FVC from baseline to Week 52.
Endpoint(s): Time to first clinical worsening event (including time to death, respiratory hospitalization, or ≥10% relative decline in % predicted FVC), Time to first acute exacerbation of ILD, Overall survival at Week 52, Change from baseline in % predicted FVC at Week 52, Change from baseline in K-BILD score at Week 52, Change from baseline in DLCO at Week 52, Change from baseline in absolute FVC at Weeks 16, 28, and 40, Change from baseline in NT-proBNP at Week 52, Change from baseline in resting supplemental oxygen use at Week 52, AEs and serious adverse events (SAEs), Clinical laboratory parameters, Vital signs, including saturation of peripheral capillary oxygenation (SpO2), 12-Lead electrocardiograms

Source: https://euclinicaltrials.eu/ctis-public/view/2023-504904-26-00